EU clinical trial 2024-515297-27-00: PRODIGE 70 - CIRCULATE - CIRCULATING TUMOR DNA BASED DECISION FOR ADJUVANT TREATMENT IN COLON CANCER STAGE II
Protocol code: PRODIGE 70
Sponsor: Centre Hospitalier Universitaire De Dijon (Hospital/Clinic/Other health care facility). Phase: Therapeutic confirmatory (Phase III). Countries: France (ongoing, recruiting).
Therapeutic area(s): Diseases [C] - Digestive System Diseases [C06]
Gender: Female, Male. Age: 18-64 years, 65+ years. Enrolment: 142.
Status: Ongoing, recruiting. Start date (EU): 2024-08-14. Decision date: 2024-08-14. Results received: No. Last updated: 2026-04-14.

Condition(s): colon carcinoma
Product: ELOXATINE 5 mg/ml, solution à diluer pour perfusion, FLUOROURACILE TEVA 1000 mg/20 ml, solution à diluer pour perfusion, FOLINIC ACID

Primary endpoint: improve 3-year DFS from 25% to 42.5% by the use of adjuvant chemotherapy
Endpoint(s): Time to Recurrence (TTR), Overall Survival (OS), compare DFS and OS in ctDNA positive versus ctDNA negative patients,, toxicities using NCI-CTC v4 classification, success rate of prognostication of stage II colo-rectal cancer

Source: https://euclinicaltrials.eu/ctis-public/view/2024-515297-27-00